EU clinical trial 2024-517819-74-00: PROCEADE PanTumor: A Phase 1b/2, Multicenter, Open Label Study of Anti-CEACAM5 Antibody-Drug Conjugate Precemtabart Tocentecan (M9140) in Participants With Advanced Pancreatic Cancer (Substudy PDAC)
Protocol code: MS202329_0010
Sponsor: Merck Healthcare KGaA (Pharmaceutical company). Phase: Phase I and Phase II (Integrated)- Other. Countries: France (ongoing, recruitment ended), Germany (authorised, recruitment pending), Spain (authorised, recruitment pending), Italy (authorised, recruitment pending), Austria (authorised, recruitment pending).
Therapeutic area(s): Diseases [C] - Neoplasms [C04]
Gender: Female, Male. Age: 18-64 years, 65+ years. Enrolment: 21.
Start date (EU): 2025-06-02. Decision date: 2025-05-05. Results received: No. Last updated: 2025-12-22.
Decision dates by country: IT: 2025-05-06, AT: 2025-05-12, DE: 2025-05-06, ES: 2025-05-07, FR: 2025-05-05

Condition(s): Pancreatic Ductal Adenocarcinoma
Product: M9140

Primary endpoint: Objective Response (OR) according to RECIST v1.1 as assessed by Investigators.
Endpoint(s): Number of Participants with Adverse Events (AEs) and Treatment Related AEs., Duration of Response (DoR) according to RECIST v1.1 as assessed by Investigators., Number of Participants with Disease Control., Time to Response according to RECIST v1.1 as assessed by Investigators., Progression-free Survival (PFS) according to RECIST v1.1 as assessed by Investigators., Pharmacokinetic (PK) Plasma Concentrations of M9140., Number of Participants with Anti-Drug Antibodies (ADA) against M9140.

Source: https://euclinicaltrials.eu/ctis-public/view/2024-517819-74-00